EU clinical trial 2024-512202-25-00: A 52-Week Open-Label Extension Study of Pimavanserin in Children and Adolescents with Irritability Associated with Autism Spectrum Disorder (ASD)
Protocol code: ACP-103-070
Sponsor: Acadia Pharmaceuticals Inc. (Pharmaceutical company). Phase: Therapeutic exploratory (Phase II). Countries: Spain (ended), Poland (ended), France (ended), Italy (ended), Hungary (ended).
Therapeutic area(s): Psychiatry and Psychology [F] - Mental Disorders [F03]
Gender: Female, Male. Age: 0-17 years. Enrolment: 191.
Status: Ended. Start date (EU): 2023-02-27. End date (EU): 2025-02-09. Decision date: 2024-08-26. Results received: Yes. Last updated: 2024-11-06.
Decision dates by country: IT: 2024-09-02, FR: 2024-08-26, HU: 2024-08-27, ES: 2024-08-27, PL: 2024-08-30

Condition(s): Irritability associated with autistic disorder in children and adolescents with ASD
Product: Pimavanserin Capsules 10 mg, Pimavanserin 34 mg Capsule, Pimavanserin 20 mg Capsule

Primary endpoint: Treatment-emergent adverse events (TEAEs) Safety will also be evaluated by analyses of the following: • Vital signs • Weight and body mass index (BMI) • 12-lead electrocardiograms (ECGs) • Physical examination results • Clinical laboratory tests (including urinalysis) and hormonal assessments • Columbia–Suicide Severity Rating Scale (C-SSRS) • Extrapyramidal Symptom Rating Scale Abbreviated (ESRS-A).
Endpoint(s): • Proportion of subjects who have at least 25% reduction in the Aberrant Behavior Checklist– Irritability (ABC-I) subscale score AND a Clinical Global Impression–Improvement (CGI-I) of irritability score of 1 (very much improved) or 2 (much improved) compared to the antecedent study baseline status at Week 52.

Source: https://euclinicaltrials.eu/ctis-public/view/2024-512202-25-00